EU clinical trial 2023-507880-20-00: Testing for the first time the effects of a new medicine in healthy people
Protocol code: SYN510CT01
Sponsor: Eurofins Optimed, Synendos Therapeutics AG (Pharmaceutical company). Phase: Human Pharmacology (Phase I)- First administration to humans. Countries: France (ended).
Therapeutic area(s): Diseases [C] - Nervous System Diseases [C10]
Gender: Female, Male. Age: 18-64 years. Enrolment: 72.
Status: Ended. Start date (EU): 2024-02-05. End date (EU): 2024-10-21. Decision date: 2024-01-15. Results received: No. Last updated: 2024-09-04.
Decision dates by country: FR: 2024-07-05

Condition(s): Psychatric disorder

Source: https://euclinicaltrials.eu/ctis-public/view/2023-507880-20-00